EU clinical trial 2024-513714-36-01: Safety and Impact of Dasatinib on Viral Persistence and Inflammation in People with HIV under Antiretroviral Treatment
Protocol code: BCN04-DASA
Sponsor: Instituto De Investigacion En Ciencias De La Salud Germans Trias I Pujol (Laboratory/Research/Testing facility). Phase: Therapeutic exploratory (Phase II). Countries: Spain (ongoing, recruitment ended).
Therapeutic area(s): Diseases [C] - Virus Diseases [C02]
Gender: Female, Male. Age: 18-64 years, 65+ years. Enrolment: 60.
Status: Ongoing, recruitment ended. Start date (EU): 2024-06-28. Decision date: 2024-06-28. Results received: No. Last updated: 2024-06-28.

Condition(s): Human immunodeficiency virus
Product: Dasatinib/Teva 50 mg επικαλυμμένα με λεπτό υμένιο δισκία, Maltodextrine powder, SPRYCEL 20 mg film-coated tablets

Primary endpoint: · Proportion of participants that develop Grade 3 or 4 treatment-related adverse events or laboratory abnormalities during the study, based on the CTCAE v5.0 grading scale., · Proportion of SAMHD1 phosphorylation in CD4+ T cells upon in-vitro T cell activation at weeks 0, 2, 12, 24, 28, 36 and 48.
Endpoint(s): Antiviral effect of dasatinib and its durability:Proviral reactivation capacity upon in-vitro T-cell activation, Resistance to HIV infection, Homeostatic proliferation, Immunomodulatory effects, Impact of dasatinib and its durability on: Inflammation and immune activation, HIV-1 reservoir, CD4+ T cell populations, Pharmacokinetics of dasatinib: · Dasatinib concentrations in plasma at weeks 0, 2, 12 and 24.

Source: https://euclinicaltrials.eu/ctis-public/view/2024-513714-36-01